EU clinical trial 2023-504041-31-00: Effect of dapagliflozin on the quality of life and exercise capacity of patients with amyloid transthyretin cardiac amyloidosis: a pilot, phase 2b study
Protocol code: DAMI
Sponsor: Fondazione Toscana Gabriele Monasterio (Patient organisation/association). Phase: Therapeutic exploratory (Phase II). Countries: Italy (ongoing, recruiting).
Therapeutic area(s): Diseases [C] - Cardiovascular Diseases [C14]
Gender: Female, Male. Age: 18-64 years, 65+ years. Enrolment: 50.
Status: Ongoing, recruiting. Start date (EU): 2023-11-17. Decision date: 2023-06-23. Results received: No. Last updated: 2024-12-02.

Condition(s): ATTR Cardiac Amyloidosis
Product: Forxiga 10 mg film-coated tablets

Primary endpoint: Absolute change in 6 minute walking distance
Endpoint(s): Proportion of patients experiencing a clinically significant increase in the Kansas City Cardiomyopathy Questionnaire overall summary score (≥5 points), Proportion of patients with meaningful change in NT-proBNP (≥20% decrease);, Any decrease in diuretic dose;, Evaluate the safety profile of dapagliflozin, in terms of adverse events recorded, compared to the SOC.

Source: https://euclinicaltrials.eu/ctis-public/view/2023-504041-31-00